EU clinical trial 2024-516067-83-00: A Phase 1/2/3 Study to Evaluate the Safety and Efficacy of a Single Dose of Autologous CRISPR-Cas9 Modified CD34+ Human Hematopoietic Stem and Progenitor Cells (CTX001) in Subjects With Severe Sickle Cell Disease
Protocol code: CTX001-121
Sponsor: Vertex Pharmaceuticals Inc. (Pharmaceutical company). Phase: Phase I and Phase II (Integrated)- First administration to humans. Countries: Belgium (ended), Italy (ended).
Therapeutic area(s): Diseases [C] - Congenital, Hereditary, and Neonatal Diseases and Abnormalities [C16]
Gender: Female, Male. Age: 0-17 years, 18-64 years. Enrolment: 9.
Status: Ended. Start date (EU): 2019-05-02. End date (EU): 2025-07-07. End date: 2025-07-08. Decision date: 2024-08-28. Results received: Yes. Last updated: 2025-03-31.
Decision dates by country: BE: 2024-08-28, IT: 2024-10-07

Condition(s): Severe sickle cell disease (SCD)
Product: PLERIXAFOR, Casgevy 4 - 13 x 10^6 cells/mL dispersion for infusion, BUSULFAN

Primary endpoint: Successful neutrophil engraftment, Time to neutrophil engraftment, Time to platelet engraftment, Safety and tolerability assessments based on adverse events (AEs), clinical laboratory values, and vital signs, Transplant-related mortality (TRM) within 100 days after CTX001 infusion, TRM within 1 year after CTX001 infusion, All-cause mortality, Proportion of subjects who have not experienced any severe VOC for at least 12 consecutive months (VF12) after CTX001 infusion. The evaluation of VF12 starts 60 days after last RBC transfusion for posttransplant support or SCD disease management
Endpoint(s): Proportion of subjects free from inpatient hospitalization for severe VOCs sustained for at least 12 months (HF12) after CTX001 infusion. The evaluation of HF12 starts 60 days after last RBC transfusion for post-transplant support or SCD disease management, Proportion of subjects with reduction in annualized rate of severe VOCs at the time of analysis from baseline by at least 90%, 80%, 75%, 50% up to 24 months after CTX001 infusion. The evaluation starts 60 days after last RBC transfusion for post-transplant support or SCD disease management, Relative change from baseline in annualized rate of severe VOCs up to 24 months after CTX001 infusion. The evaluation starts 60 days after last RBC transfusion for post-transplant support or SCD disease management, Duration of severe VOC free in subjects who have achieved VF12, Relative change from baseline in rate of inpatient hospitalizations for severe VOCs up to 24 months after CTX001 infusion. The evaluation starts 60 days after last RBC transfusion for post-transplant support or SCD disease management, Relative change from baseline in annualized duration of hospitalization for severe VOCs up to 24 months after CTX001 infusion. The evaluation starts 60 days after last RBC transfusion for post-transplant support or SCD disease management, Proportion of subjects with sustained HbF ≥20% at the time of analysis for at least 3 months, 6 months, or 12 months. The evaluation starts 60 days after last RBC transfusion for posttransplant support or SCD disease management, Change in number of units of RBCs transfused for SCD-related indications over time, HbF concentrations over time, Hemoglobin (Hb) concentrations over time, Change from baseline in reticulocyte count (percent reticulocytes and absolute reticulocyte count) over time, Change from baseline in indirect bilirubin over time, Change from baseline in haptoglobin over time, Change from baseline in lactate dehydrogenase over time, Proportion of alleles with intended genetic modification present in peripheral blood leukocytes over time, Proportion of alleles with intended genetic modification present in CD34+ cells of the bone marrow over time, Change in patient reported outcomes (PROs) over time in adults (≥18 years) using; - Pain-scale: 11-point numerical rating scale (NRS) - Functional assessment of cancer therapy-bone marrow transplant (FACT-BMT) - Adult Sickle Cell Quality of Life Measurement System (ASCQ-Me) - EuroQol Quality of Life Scale (EQ-5D-5L), Change in PROs over time in adolescents (12 to <18 years of age) using; - Pain-scale: 11-point NRS - Pediatric Quality of Life Inventory (PedsQL Teen selfreport and parent proxy versions) - PedsQL SCD module (Teen self-report and parent proxy versions) - EQ-5D-Youth (EQ-5D-Y self-report and parent proxy version)

Source: https://euclinicaltrials.eu/ctis-public/view/2024-516067-83-00